EU clinical trial 2023-507001-34-00: (14308) Randomized, double-blind, placebo-controlled, parallel-group, multi-center study to evaluate the hemodynamic effects of Riociguat (BAY 63-2521) as well as safety and kinetics in patients with pulmonary hypertension associated with left ventricular systolic dysfunction.
Protocol code: 14308
Sponsor: Bayer AG (Pharmaceutical company). Phase: Therapeutic exploratory (Phase II). Countries: Italy (ended), Czechia (ended), Germany (ended).
Therapeutic area(s): Diseases [C] - Respiratory Tract Diseases [C08]
Gender: Female, Male. Age: 18-64 years, 65+ years. Enrolment: 68.
Status: Ended. Start date (EU): 2010-04-29. End date (EU): 2025-07-23. End date: 2025-07-24. Decision date: 2024-03-25. Results received: Yes. Last updated: 2025-04-29.
Decision dates by country: DE: 2024-03-25, IT: 2024-04-26, CZ: 2024-03-26

Condition(s): Patients symptomatic with pulmonary hypertension associated with left ventricular systolic dysfunction (PH-sLVD)
Product: Riociguat Bayer, Riociguat Bayer, Placebo for riociguat, Riociguat Bayer

Primary endpoint: Change from baseline to week 16 in Pulmonary artery mean pressure (PAPmean) at rest
Endpoint(s): Change from baseline in venous oxygen saturation (SvO2) measured by RHC, Change from baseline in pulmonary vascular resistance (PVR), systemic vascular resistance (SVR), transpulmonary pressure gradient (TPG) and pulmonary capillary wedge pressure (PCWP), all measured by right heart catheter (RHC)., Change from baseline in tricuspid annular plane systolic excursion (TAPSE), systolic pulmonary arterial pressure (PAPsyst) and left ventricular ejection fraction (LVEF), ratio of mitral peak velocity of early filling to mitral peak velocity of late filling (E/A), ratio of mitral velocity of early filling to early diastolic velocity of the mitral annulus (E/E'), E wave deceleration time all measured by echocardiography, Change from baseline in WHO class, Change from baseline in 6-minute walking distance (6MWD) and in Borg CR 10 scale, measured at the end of the 6MWD test, Change from baseline in quality of life (QoL) scores: EQ-5D questionnaire (EQ-5D), Minnesota Living with Heart Failure Questionnaire (MLHF), Change from baseline in cardiac biomarkers N-terminal pro-brain natriuretic peptide (NT-pro BNP) and troponin T, Change from baseline in exploratory biomarkers asymmetric dimethyl arginine (ADMA) and osteopontin (section 14.10), Events of special interest considered for the calculation of the combined endpoint "time to clinical worsening" (see section 7.3.8), Events of special safety interest (see section 7.5.1.6), All-cause mortality, Composite endpoint as defined by: time to death from cardiovascular causes or first hospitalization for a cardiovascular event, including heart failure, acute myocardial infarction, stroke or ventricular arrhythmia.

Source: https://euclinicaltrials.eu/ctis-public/view/2023-507001-34-00